EU clinical trial 2025-522962-58-00: SKIPP2: Cabozantinib Dose Skipping as an Alternative to Dose Reductions
Sponsor: Leids Universitair Medisch Centrum (LUMC) (Hospital/Clinic/Other health care facility). Phase: Therapeutic exploratory (Phase II). Countries: Netherlands (ongoing, recruiting).
Therapeutic area(s): Diseases [C] - Neoplasms [C04]
Gender: Female, Male. Age: 18-64 years, 65+ years. Enrolment: 34.
Status: Ongoing, recruiting. Start date (EU): 2026-01-26. Decision date: 2025-11-10. Results received: No. Last updated: 2026-07-31.

Condition(s): Renal cell carcinom
Product: Cabozantinib Ipsen 20 mg film-coated tablets

Primary endpoint: Comparison of the area under the concentration-time curve (AUC0-72): calculated by modelling a pharmacokinetic curve from plasma concentrations cabozantinib, obtained by pharmacokinetic samples from 0 to 72 hours after ingestion of cabozantinib. The AUC0-72 of the standard and experimental regimen will be compared. It is defined as comparable if the geometric mean ratio is within the range of 0.8 – 1.25., Comparison of the blood trough concentration (Ctrough): defined as the plasma concentration of cabozantinib before ingestion of a dose of cabozantinib. The Ctrough of the standard and experimental regimen will be compared. It is defined as comparable if the geometric mean ratio is within the range of 0.8 – 1.25.
Endpoint(s): Health-care use: both medication use and hospitalisations will be registered from the patients’ hospital records, EQ-5D-5L Quality of Life (See Appendix 5): the EQ-5D-5L questionnaire will be taken after at least four weeks on treatment in the first part and after four weeks in the second part., FKSI-19 Quality of Life (See Appendix 6): the FKSI-19 questionnaire will be taken after at least four weeks on treatment in the first part and after four weeks in the second part., Adverse events: defined as any symptom, sign, illness, or untoward experience (including a clinically significant laboratory finding classified as Grade 3 or higher by the National Cancer Institute’s Common Terminology Criteria for Adverse Events (CTCAE) v5.0) (28) that develops or worsens during the course of the study, whether or not the event is considered related to study drug. Such an event should be recorded as an adverse event only after t, Percentage of patients preferring to take cabozantinib in fed state: Question whether patients would prefer to continue to take cabozantinib in fed state or to recommence taking cabozantinib in fasted state

Source: https://euclinicaltrials.eu/ctis-public/view/2025-522962-58-00